EU clinical trial 2023-506739-14-00: An Open-Label Study to Investigate the Safety, Tolerability, and Pharmacokinetics/Pharmacodynamics of Risdiplam (RO7034067) in Adult and Pediatric patients with Spinal Muscular Atrophy
Protocol code: BP39054
Sponsor: F. Hoffmann-La Roche AG (Pharmaceutical company). Phase: Therapeutic exploratory (Phase II). Countries: Netherlands (ended), Italy (ended), France (ended), Poland (ended), Belgium (ended).
Therapeutic area(s): Diseases [C] - Nervous System Diseases [C10]
Gender: Female, Male. Age: 0-17 years, 18-64 years. Enrolment: 110.
Status: Ended. Start date (EU): 2017-05-12. End date (EU): 2025-02-07. End date: 2025-02-08. Decision date: 2023-12-07. Results received: Yes. Last updated: 2024-12-17.
Decision dates by country: PL: 2024-01-10, IT: 2023-12-13, BE: 2024-01-24, NL: 2023-12-07, FR: 2023-12-11

Condition(s): Spinal Muscular Atrophy (SMA)
Product: RO7034067

Primary endpoint: 1. Incidence and severity of adverse events and serious adverse events with severity determined according to National Cancer Institute Common Terminology Criteria for Adverse Events scale, Version 4.0, 2. Incidence of treatment discontinuations due to adverse events, 3. Incidence of abnormal vital signs, laboratory, and ECG abnormalities, 4. Incidence of clinically significant findings on ophthalmological examination, 5. Incidence of clinically significant findings on neurological examination, 6. Incidence of clinically significant findings in Physical examination, 7. Incidence of emergence or worsening of symptoms as measured by the Columbia-Suicide Severity Rating Scale (C-SSRS) (adult version for adults and adolescents, pediatric version for patients aged 6-11 years), 8. Mean plasma concentrations of Risdiplam and metabolites, 9. Peak plasma concentration (Cmax), 10. Area under the curve (AUC), 11. Concentration at the end of a dosing interval (Ctrough)
Endpoint(s): 1. SMN mRNA levels in blood, 2. SMN protein levels in blood

Source: https://euclinicaltrials.eu/ctis-public/view/2023-506739-14-00